EU clinical trial 2022-501709-11-00: A single arm, open-label Phase 3b study to describe the safety and tolerability of ivosidenib in combination with azacitidine in adult patients newly diagnosed with IDH1m acute myeloid leukemia (AML) ineligible for intensive induction chemotherapy; ALIDHE
Protocol code: DIM-95031-006
Sponsor: Servier Affaires Medicales (Pharmaceutical company). Phase: Therapeutic confirmatory (Phase III). Countries: France (ongoing, recruitment ended), Netherlands (ongoing, recruitment ended), Spain (ongoing, recruitment ended), Austria (ended), Belgium (ongoing, recruitment ended), Italy (ongoing, recruitment ended), Greece (ongoing, recruitment ended), Hungary (ended), Ireland (authorised, recruitment pending), Romania (ongoing, recruitment ended), Portugal (ended).
Therapeutic area(s): Diseases [C] - Neoplasms [C04]
Gender: Female, Male. Age: 18-64 years, 65+ years. Enrolment: 179.
Start date (EU): 2023-06-06. Decision date: 2023-04-25. Results received: No. Last updated: 2026-04-27.
Decision dates by country: AT: 2023-05-02, PT: 2025-05-23, FR: 2023-04-25, IE: 2023-11-03, RO: 2023-10-09, HU: 2023-10-30, IT: 2023-04-28, NL: 2023-05-01, GR: 2023-11-03, ES: 2023-04-28, BE: 2023-05-02

Condition(s): Isocitrate deshydrogenase1 mutation-positive (IDH1m) acute myeloid leukemia (AML)
Product: Vidaza 25 mg/ml powder for suspension for injection, AG-120/S95031 250mg film-coated tablet

Primary endpoint: • Adverse events (AEs), serious adverse events (SAEs), adverse events of special interest (AESIs), AEs leading to ivosidenib + azacytidine discontinuation, AEs leading to ivosidenib or azacitidine interruption, AEs leading to ivosidenib or azacitidine dose reduction, AEs leading to death • Clinical laboratory anomalies assessed as AEs • Patients requiring transfusion (platelet and RBC) and number of units transfused • Rate of infections
Endpoint(s): • Event-free survival (EFS) • Complete remission (CR) • CR + CR with partial hematologic recovery (CRh) • CR + CR with incomplete hematologic recovery (CRi) • Duration of response (DOR) (overall and by response type) • Time to response (TTR) • Overall survival (OS) • Objective response (OR), • Hematological Malignancy-Patient-Reported outcome (HM-PRO) • Family Reported Outcome Measure 16 (FROM-16) (for caregivers/family), • 5 level EuroQol 5-dimensions (EQ-5D-5L) • Length of hospital stay (LOS) • Outpatient visits • Emergency room (ER) visits • Proportion of days at home, • Molecular profiling method • Time to results • Allele subtypes • Co-occurring mutation profiles

Source: https://euclinicaltrials.eu/ctis-public/view/2022-501709-11-00